EU clinical trial 2024-511654-42-00: An Open-Label, Multicenter, Extension Trial to Evaluate the Long-Term Safety and Efficacy of Apitegromab in Patients with Type 2 and Type 3 Spinal Muscular Atrophy Who Completed Previous Investigational Trials of Apitegromab (ONYX)
Protocol code: SRK-015-004
Sponsor: Scholar Rock Inc. (Pharmaceutical company). Phase: Therapeutic confirmatory (Phase III). Countries: Poland (ongoing, recruitment ended), Belgium (ongoing, recruitment ended), France (ongoing, recruitment ended), Italy (ongoing, recruitment ended), Netherlands (ongoing, recruitment ended), Germany (ongoing, recruitment ended), Spain (ongoing, recruitment ended).
Therapeutic area(s): Diseases [C] - Congenital, Hereditary, and Neonatal Diseases and Abnormalities [C16]
Gender: Female, Male. Age: 0-17 years, 18-64 years. Enrolment: 125.
Status: Ongoing, recruitment ended. Start date (EU): 2023-06-28. Decision date: 2024-03-25. Results received: No. Last updated: 2026-02-26.
Decision dates by country: BE: 2024-04-11, DE: 2024-04-02, ES: 2024-03-25, NL: 2024-03-25, IT: 2024-04-08, PL: 2024-04-19, FR: 2024-03-27

Condition(s): Spinal Muscular Atrophy (SMA)
Product: APITEGROMAB

Primary endpoint: Incidence of treatment-emergent adverse event (TEAEs) and serious adverse event (SAEs) by severity
Endpoint(s): HFMSE total score at prespecified time points (excludes TOPAZ Cohort 1 patients), RULM total score at prespecified time points (excludes TOPAZ Cohort 1 patients), Number of WHO motor development milestones attained at prespecified time points (excludes TOPAZ Cohort 1 patients), RHS total score and results for 6-Minute Walk Test, 30-Second Sit-to-Stand, 10-Meter Walk/Run (from the RHS), and timed rise from floor (from the RHS) at prespecified time points (TOPAZ Cohort 1 patients only)

Source: https://euclinicaltrials.eu/ctis-public/view/2024-511654-42-00